EU clinical trial 2025-522343-18-00: A Phase 2, Randomized, Double-Blind, Placebo-Controlled Trial to Assess the Efficacy and Safety of surlorian (ARM210, S48168) in Adults with Autosomal Dominant RYR1-Related Myopathy
Protocol code: CL2-210-02
Sponsor: Rycarma Therapeutics Inc. (Pharmaceutical company). Phase: Therapeutic exploratory (Phase II). Countries: Netherlands (authorised, recruitment pending), Spain (authorised, recruitment pending), France (authorised, recruitment pending), Germany (authorised, recruiting).
Therapeutic area(s): Diseases [C] - Musculoskeletal Diseases [C05]
Gender: Female, Male. Age: 18-64 years, 65+ years. Enrolment: 41.
Start date (EU): 2026-06-12. Decision date: 2026-04-02. Results received: No. Last updated: 2026-04-07.
Decision dates by country: ES: 2026-04-07, FR: 2026-04-07, DE: 2026-04-02, NL: 2026-04-02

Condition(s): Autosomal Dominant RYR1-Related Myopathy
Product: Surlorian placebo, Surlorian

Primary endpoint: Change from Day 1 in the 1-MSST measurements after approximately 28 days of dosing between active treatment and placebo.
Endpoint(s): 1. Change from Day 1 in the 6 MNWT, TUG, 4 SCT, and for weight-scaled muscle strength as measured by QMA and MMT after approximately 28 days of dosing between active treatment and placebo, 2. Change from Day 1 in the PROMIS-F, PROMIS PF and IPAQ questionnaires after approximately 28 days of dosing between active treatment and placebo, 3. Incidence of AEs, serious adverse events (SAEs), treatment-emergent adverse events (TEAEs) and adverse events of special interest (AESIs) throughout the trial, 4. Change from Day 1 in safety assessments (vital signs, physical examinations, laboratory safety tests, electrocardiograms [ECGs], and Columbia Suicide Severity Rating Scale [C‑SSRS])

Source: https://euclinicaltrials.eu/ctis-public/view/2025-522343-18-00